EU clinical trial 2024-513671-40-00: VAC-WARTS Efficacy of the nonavalent HPV vaccine in the treatment of difficult-to-treat palmo-plantar warts
Protocol code: APHP200046
Sponsor: Assistance Publique Hopitaux De Paris (Hospital/Clinic/Other health care facility). Phase: Therapeutic confirmatory (Phase III). Countries: France (ongoing, recruiting).
Therapeutic area(s): Diseases [C] - Virus Diseases [C02]
Gender: Female, Male. Age: 0-17 years, 18-64 years, 65+ years. Enrolment: 146.
Status: Ongoing, recruiting. Start date (EU): 2022-06-29. Decision date: 2024-07-24. Results received: No. Last updated: 2025-05-16.

Condition(s): HPV vaccine
Product: SODIUM CHLORIDE, Gardasil 9 suspension for injection in a pre-filled syringe. Human Papillomavirus 9-valent Vaccine (Recombinant, adsorbed)

Primary endpoint: Complete remission of cutaneous warts 7 months after the first injection of the vaccine
Endpoint(s): Quality of Life will be evaluated with QoL Questionnaire (DLQI) at M0, M2, M6, M7, Pain will be assess using VAS at M0, M2, M6, M7, Functional discomfort for walking and functional disability in hands will be evaluated using the Revised Foot Function index or Cochin hand function scale respectively at M0, M2, M6, M7, Partial remission of cutaneous warts 7 months after the first injection of the vaccine., Number of warts appeared at M2, M6, M7

Source: https://euclinicaltrials.eu/ctis-public/view/2024-513671-40-00